EU clinical trial 2023-509919-89-00: RAndom sTArT Ovarian stimUlatIon (RSOS) in eLective oocyte cryopreservation cycLEs (RATATOUILLE): a single-center, non-inferiority, randomised controlled trial
Sponsor: UZ Brussel (Hospital/Clinic/Other health care facility). Phase: Therapeutic use (Phase IV). Countries: Belgium (ongoing, recruiting).
Therapeutic area(s): Phenomena and Processes [G] - Reproductive and Urinary Physiological Phenomena [G08]
Gender: Female. Age: 18-64 years. Enrolment: 277.
Status: Ongoing, recruiting. Start date (EU): 2025-02-19. Decision date: 2024-10-10. Results received: No. Last updated: 2025-02-05.

Condition(s): Prevention of female infertility.
Product: Duphaston 10 mg comprimés pelliculés, Bemfola 300 IU/0.50 mL solution for injection in pre-filled pen, Duphaston 10 mg Filmtabletten, Gonapeptyl Daily 0,1 mg/1 ml, solution injectable, Duphaston 10 mg filmomhulde tabletten

Primary endpoint: Total number of mature cryopreserved oocytes per ovarian stimulation (OS) cycle in elective oocyte cryopreservation.
Endpoint(s): • The total number of oocytes retrieved, • Total consumption of gonadotropins (IU) used during Ovarian Stimulation, • Duration of Ovarian Stimulation, defined as the time from the first day of stimulation until the application of the trigger for the final oocyte maturation

Source: https://euclinicaltrials.eu/ctis-public/view/2023-509919-89-00